EU clinical trial 2026-526160-21-00: Measles-mumps-rubella vaccine (MMR) at 6 months of age: Long-term follow-up
Sponsor: Rigshospitalet (Hospital/Clinic/Other health care facility). Phase: Therapeutic use (Phase IV). Countries: Denmark (ongoing, recruiting).
Therapeutic area(s): Diseases [C] - Virus Diseases [C02]
Gender: Female, Male. Age: 0-17 years. Enrolment: 1000.
Status: Ongoing, recruiting. Start date (EU): 2026-06-16. Decision date: 2026-06-08. Results received: No. Last updated: 2026-06-08.

Condition(s): Prevention of measles, mumps, and rubella by vaccination
Product: MEASLES, COMBINATIONS WITH MUMPS AND RUBELLA, LIVE ATTENUATED

Primary endpoint: To measure the level of specific immunity, measured as level of measles neutralising antibodies by plaque-reduction neutralisation test 1-3 years after routine MMR vaccination at 4 years of age
Endpoint(s): • Level of specific immunity, measured as level of measles neutralising antibodies by plaque-reduction neutralisation test at least 1 year after MMR2. Level of specific immunity, measured as level of IgG against measles, mumps, and rubella at least 1 year after MMR2.

Source: https://euclinicaltrials.eu/ctis-public/view/2026-526160-21-00